EU clinical trial 2022-502620-49-00: A Study Evaluating Pharmacokinetic Similarity of ABP 206 Compared With OPDIVO® (Nivolumab) in Subjects With Resected Stage III and Stage IV Melanoma in the Adjuvant Setting
Protocol code: 20220083
Sponsor: Amgen Inc. (Pharmaceutical company). Phase: Human Pharmacology (Phase I)- Bioequivalence Study. Countries: Italy (ended), Germany (ended), Netherlands (ended), France (ended), Spain (ended), Croatia (ended), Lithuania (ended), Romania (ended).
Therapeutic area(s): Diseases [C] - Neoplasms [C04]
Gender: Female, Male. Age: 18-64 years, 65+ years. Enrolment: 156.
Status: Ended. Start date (EU): 2023-08-01. End date (EU): 2025-10-29. End date: 2025-10-31. Decision date: 2023-06-21. Results received: No. Last updated: 2025-12-05.
Decision dates by country: FR: 2023-06-21, DE: 2023-06-21, IT: 2023-06-26, NL: 2023-06-26, HR: 2023-06-26, LT: 2023-09-12, RO: 2023-12-18, ES: 2023-07-26

Condition(s): Resected Melanoma Stage III or Stage IV

Source: https://euclinicaltrials.eu/ctis-public/view/2022-502620-49-00